EU clinical trial 2024-514538-19-00: A 24-week with possible extension, prospective, multicenter, randomized, double blind, placebo-controlled, 2-parallel group with a randomization 1:1, phase III study to compare efficacy and safety of oral masitinib to placebo in treatment of patients with Smouldering or Indolent Severe Systemic mastocytosis with handicap, unresponsive to optimal symptomatic treatment
Protocol code: AB15003
Sponsor: Ab Science (Pharmaceutical company). Phase: Therapeutic confirmatory (Phase III). Countries: Poland (ended), France (ended), Spain (ended).
Therapeutic area(s): Diseases [C] - Hemic and Lymphatic Diseases [C15]
Gender: Female, Male. Age: 18-64 years, 65+ years. Enrolment: 70.
Status: Ended. Start date (EU): 2025-11-26. End date (EU): 2026-07-03. Decision date: 2025-01-30. Results received: No. Last updated: 2025-12-01.
Decision dates by country: FR: 2025-01-30, PL: 2025-01-30, ES: 2025-01-30

Condition(s): Mastocytosis
Product: Placebo to 100mg masitinib, Placebo to 200mg masitinib, masitinib, masitinib

Primary endpoint: The primary analysis (response on 3 handicaps) will be done on the ITT population. It is based on the cumulative response by patient handicap from week 8 to week 24
Endpoint(s): 1.Handicaps, 2. Biological and Skin Parameters, 3. Quality of Life

Source: https://euclinicaltrials.eu/ctis-public/view/2024-514538-19-00